EU clinical trial 2024-512862-32-00: (APOLLO)Neo-adjuvant Pembrolizumab in vulvar squamous cell carcinoma: a clinical proof-of-concept study
Protocol code: NL82378.058.22
Sponsor: Leids Universitair Medisch Centrum (LUMC) (Hospital/Clinic/Other health care facility). Phase: Therapeutic exploratory (Phase II). Countries: Netherlands (ended).
Therapeutic area(s): Analytical,Diagnostic,Therapeutic Techniques and Equipment [E]-Surgical Procedures, Operative [E04]; Diseases [C] - Neoplasms [C04]
Gender: Female. Age: 18-64 years, 65+ years. Enrolment: 40.
Status: Ended. Start date (EU): 2023-05-11. End date (EU): 2026-01-09. Decision date: 2024-09-10. Results received: No. Last updated: 2024-09-10.

Condition(s): Vulvar squamous cell carcinoma
Product: KEYTRUDA 25 mg/mL concentrate for solution for infusion

Primary endpoint: Clinical efficacy of neoadjuvant PD-1 blockade in VSCC, measured by objective change in tumour size (according to RECIST1.1), The activation, proliferation and migration of the CD4+CD39+PD-1+ intratumoral Tcell population.
Endpoint(s): Pathological complete responses (pCR) at time of surgery, Feasibility (defined as delay in planned surgery and surgical outcomes), safety according to NCI-CTC version 5.0, The activation, proliferation and migration of the CD8+CD103+CD39+PD-1+ intratumoral T-cell population upon PD-1 blockade

Source: https://euclinicaltrials.eu/ctis-public/view/2024-512862-32-00